EU clinical trial 2024-514242-36-00: LEVOSAH - Pilot study comparing the effectiveness of adding treatment with Levosimendan to usual care for the management of the acute phase of aneurysmal subarachnoid hemorrhages
Protocol code: APHP200175
Sponsor: Assistance Publique Hopitaux De Paris (Hospital/Clinic/Other health care facility). Phase: Therapeutic exploratory (Phase II). Countries: France (ongoing, recruiting).
Therapeutic area(s): Phenomena and Processes [G] - Physiological processes [G07]
Gender: Female, Male. Age: 18-64 years, 65+ years. Enrolment: 30.
Status: Ongoing, recruiting. Start date (EU): 2024-11-04. Decision date: 2024-11-04. Results received: No. Last updated: 2025-09-16.

Condition(s): subarachnoid hemorrhages of aneurysmal origin (HSAa)
Product: GLUCOSE 5 % B.BRAUN, solution pour perfusion, ZIMINO 2,5 mg/ml, solution à diluer pour perfusion

Primary endpoint: the occurrence of cerebral arterial vasospasm within 14 days of the bleeding
Endpoint(s): the cumulative incidence of death rate, ICDs and vasospasms, The mRS score at 6 months, Impact of Levosimendan treatment on cardiac dysfunction

Source: https://euclinicaltrials.eu/ctis-public/view/2024-514242-36-00